EU clinical trial 2024-518273-34-02: Safety, Tolerability and Efficacy against Controlled Human Malaria Infection of PfSPZ-LARC2 Vaccine in Malaria-naïve Adults
Protocol code: LARC-Tu
Sponsor: Universitaetsklinikum Tuebingen AöR (Hospital/Clinic/Other health care facility). Phase: Human Pharmacology (Phase I)- Other. Countries: Germany (ongoing, recruiting).
Therapeutic area(s): Diseases [C] - Parasitic Diseases [C03]
Gender: Female, Male. Age: 18-64 years. Enrolment: 42.
Status: Ongoing, recruiting. Start date (EU): 2026-03-02. Decision date: 2026-01-26. Results received: No. Last updated: 2026-03-25.
Decision dates by country: DE: 2026-03-04

Condition(s): Malaria

Source: https://euclinicaltrials.eu/ctis-public/view/2024-518273-34-02